EU clinical trial 2023-503270-20-00: Randomized, non-comparative, open-label early phase Ib study with OBT076 or OBT076 followed by Balstilimab in patients with Adenoid Cystic Carninoma of the Head and Neck
Protocol code: GORTEC 2023-01
Sponsor: Groupe Oncologie Radiotherapie Tete Cou (Patient organisation/association). Phase: Human Pharmacology (Phase I)- Other. Countries: France (ended).
Therapeutic area(s): Diseases [C] - Neoplasms [C04]
Gender: Female, Male. Age: 18-64 years, 65+ years. Enrolment: 32.
Status: Ended. Start date (EU): 2023-11-29. End date (EU): 2024-10-09. Decision date: 2023-08-02. Results received: No. Last updated: 2024-06-03.

Condition(s): recurrent or metastatic Adenoid Cystic Carcinoma of the Head and Neck

Source: https://euclinicaltrials.eu/ctis-public/view/2023-503270-20-00